EU clinical trial 2023-507521-41-01: A Phase 1, Randomized, Double-Blind, Placebo-Controlled Study to Evaluate the Safety, Tolerability, Pharmacokinetics and Pharmacodynamics of Pimozide after Multiple Dose Administration in Subjects with Rheumatoid Arthritis
Protocol code: GBP-NIB1-101
Sponsor: Generos Biopharma Ltd. (Pharmaceutical company). Phase: Human Pharmacology (Phase I)- Other. Countries: Bulgaria (authorised, recruitment pending).
Therapeutic area(s): Diseases [C] - Immune System Diseases [C20]
Gender: Female, Male. Age: 18-64 years, 65+ years. Enrolment: 24.
Status: Authorised, recruitment pending. Decision date: 2023-11-20. Results received: No. Last updated: 2023-11-20.

Condition(s): rheumatoid arthritis

Source: https://euclinicaltrials.eu/ctis-public/view/2023-507521-41-01